EU clinical trial 2024-511548-19-00: Phase 1/1b, Multicenter, Open-Label, Dose Escalation and Dose Expansion Study of RMC-6291 Monotherapy in Subjects with Advanced KRASG12C Mutant Solid Tumors.
Protocol code: RMC-6291-001
Sponsor: Revolution Medicines Inc. (Pharmaceutical company). Phase: Human Pharmacology (Phase I)- First administration to humans. Countries: France (ongoing, recruitment ended), Czechia (ongoing, recruitment ended), Poland (ongoing, recruitment ended), Italy (ongoing, recruitment ended), Spain (ongoing, recruitment ended).
Therapeutic area(s): Diseases [C] - Neoplasms [C04]
Gender: Female, Male. Age: 18-64 years, 65+ years. Enrolment: 104.
Status: Ongoing, recruitment ended. Start date (EU): 2022-12-13. Decision date: 2024-04-01. Results received: No. Last updated: 2026-06-08.
Decision dates by country: CZ: 2024-04-03, PL: 2024-04-04, IT: 2024-04-03, ES: 2024-04-01, FR: 2024-04-05

Condition(s): Pancreatic Ductal Adenocarcinoma, Colorectal Cancer (CRC), Non-Small Cell Lung Cancer (NSCLC), Advanced Solid Tumor

Source: https://euclinicaltrials.eu/ctis-public/view/2024-511548-19-00